EU clinical trial 2024-513605-31-00: A phase 2, randomized, open-label, multicenter study to evaluate safety and efficacy of single agent selinexor versus treatment of physician’s choice in patients with previously treated myelofibrosis.
Protocol code: XPORT-MF-035
Sponsor: Karyopharm Therapeutics Inc. (Pharmaceutical company). Phase: Therapeutic exploratory (Phase II). Countries: Spain (ended), Italy (ended).
Therapeutic area(s): Diseases [C] - Neoplasms [C04]
Gender: Female, Male. Age: 18-64 years. Enrolment: 28.
Status: Ended. Start date (EU): 2021-10-21. End date (EU): 2026-07-21. Decision date: 2024-10-25. Results received: No. Last updated: 2026-06-09.
Decision dates by country: IT: 2024-11-04, ES: 2024-10-25

Condition(s): Myelofibrosis
Product: SELINEXOR

Primary endpoint: Rate of Spleen Volume Reduction of > or = 35% (SVR35)
Endpoint(s): Rate of Total Symptom Score reduction of > or = 50% (TSS50) in the myelofibrosis symptom assessment form (MFSAF) V4.0, based on local assessment, Rate of Spleen Volume Reduction of > or =25% (SVR25), Overall survival (OS), Anemia response as defined per the IWG-MRT criteria, based on local assessment • Duration of SVR35 and SVR25 • Duration of TSS50 based on local assessment • ORR (Complete Response [CR] + Partial Response [PR] + Clinical Improvement [CI]) by IWG-MRT criteria, based on local assessment, The occurrence, nature, and severity of AEs, Population PK derived parameters: • AUC • Cmax

Source: https://euclinicaltrials.eu/ctis-public/view/2024-513605-31-00